EU clinical trial 2025-522448-41-00: OmaMig Pilot: An open-label, phase IIa, single arm pilot study evaluating the potential clinical benefit and safety of omalizumab in adults with episodic migraine.
Protocol code: OmaMig Pilot
Sponsor: Oslo University Hospital HF (Hospital/Clinic/Other health care facility). Phase: Therapeutic exploratory (Phase II). Countries: Norway (authorised, recruitment pending).
Therapeutic area(s): Diseases [C] - Nervous System Diseases [C10]
Gender: Female, Male. Age: 18-64 years. Enrolment: 25.
Status: Authorised, recruitment pending. Decision date: 2026-03-31. Results received: No. Last updated: 2026-03-31.

Condition(s): Episodic migraine
Product: Xolair 300 mg solution for injection in pre-filled syringe

Primary endpoint: Change in number of migraine days from screening period (week -4 –baseline) to week 8–12.
Endpoint(s): Incidence of adverse events (AEs) and serious adverse events (SAEs) at 16 weeks, Suspected unexpected serious adverse reaction (SUSAR)., Withdrawals, Intensity and duration, Type and dose of medication, Self-assessed efficacy of rescue treatment, ≥50% reduction in attack frequency (week -4 –baseline) to week 8–12, Numbers of patients within each category at 12 weeks, Reported IgE value at baseline and 16 weeks, Change in number of migraine days from screening period (week -4 –baseline) to week 12–16

Source: https://euclinicaltrials.eu/ctis-public/view/2025-522448-41-00